EU clinical trial 2025-522729-36-00: Phase 1/2 Study to Evaluate the Safety, Tolerability, Pharmacokinetics, and Antiviral Activity of GS-4321 in Healthy Participants and Participants With Chronic Hepatitis Delta.
Protocol code: GS-US-567-6968
Sponsor: Gilead Sciences Inc. (Pharmaceutical company). Phase: Phase I and Phase II (Integrated)- First administration to humans. Countries: Italy (authorised, recruiting), Romania (ongoing, recruiting), Germany (authorised, recruiting), Bulgaria (authorised, recruiting).
Therapeutic area(s): Diseases [C] - Virus Diseases [C02]
Gender: Female, Male. Age: 18-64 years, 65+ years. Enrolment: 50.
Start date (EU): 2026-03-11. Decision date: 2026-02-09. Results received: No. Last updated: 2026-03-10.
Decision dates by country: BG: 2026-02-11, IT: 2026-02-11, RO: 2026-02-16, DE: 2026-02-09

Condition(s): Chronic Hepatitis Delta.
Product: GS-4321 PLACEBO

Primary endpoint: Part A Endpoints : Incidences of treatment-emergent adverse events (TEAEs), serious adverse events (SAEs), and graded laboratory abnormalities. Serum PK parameters AUClast, AUCinf, Cmax, Tmax, and t1/2 of GS-4321, as applicable. Additional parameters may be evaluated as applicable., Part B Endpoints: Proportion of participants with combined response (defined as undetectable hepatitis delta virus [HDV] RNA or ≥ 2 log10 decrease in HDV RNA from baseline and normal alanine aminotransferase [ALT] (ALT < upper limit of normal [ULN]) at Week 24). Incidences of TEAEs, SAEs, and graded laboratory abnormalities
Endpoint(s): Part A Endpoints: Proportion of participants who develop antidrug antibodies (ADAs) after administration of a single dose of GS-4321 and ADA titer characterization, Part B Endpoints: Serum PK parameters AUCtau, Cmax, Tmax, and Ctrough of GS-4321, as applicable. Additional parameters may be evaluated, as applicable., Part B Endpoints: Proportion of participants with undetectable HDV RNA or ≥ 2 log10 decrease in HDV RNA from baseline and normal ALT (ALT < ULN) at Weeks 4, 8, 12, 16, 20, 36, 48, 60, 72, 84, and 96, Part B Endpoints: Change from baseline in HDV RNA at Weeks 4, 8, 12, 16, 20, 24, 36, 48, 60, 72, 84, and 96, Part B Endpoints: Proportion of participants with undetectable HDV RNA at Weeks 4, 8, 12, 16, 20, 24, 36, 48, 60, 72, 84, and 96, Part B Endpoints: Proportion of participants with undetectable HDV RNA or ≥ 2 log10 decrease in HDV RNA from baseline at Weeks 4, 8, 12, 16, 20, 24, 36, 48, 60, 72, 84, and 96, Part B Endpoints: Change in liver stiffness by elastography from baseline at Weeks 24, 48, and 96, Part B Endpoints: Proportion of participants with normal ALT at Weeks 4, 8, 12, 16, 20, 24, 36, 48, 60, 72, 84, and 96, Part B Endpoints: Proportion of participants who develop ADAs after administration of multiple doses of GS-4321 and ADA titer characterization, Part B Endpoints: Characterize if emergent variants are associated with reduced susceptibility to GS-4321 in vitro and virologic failure in participants with CHD

Source: https://euclinicaltrials.eu/ctis-public/view/2025-522729-36-00